EU clinical trial 2024-514705-62-00: A phase III randomized trial evaluating chemotherapy followed by pelvic reirradiation versus chemotherapy alone as pre-operative treatment for locally recurrent rectal cancer (GRECCAR – PRODIGE – FRENCH) - GRECCAR 15
Protocol code: CHUBX 2017/52
Sponsor: Centre Hospitalier Universitaire De Bordeaux (Hospital/Clinic/Other health care facility). Phase: Therapeutic confirmatory (Phase III). Countries: France (ended).
Therapeutic area(s): Diseases [C] - Neoplasms [C04]
Gender: Female, Male. Age: 18-64 years, 65+ years. Enrolment: 186.
Status: Ended. Start date (EU): 2019-07-08. End date (EU): 2026-02-10. Decision date: 2024-07-04. Results received: No. Last updated: 2024-07-04.

Condition(s): Recurrent rectal cancer after local excision, Rectal cancer
Product: CAMPTO 20 mg/mL, solution à diluer pour perfusion (IV), ELVORINE 100 mg/10 mL, solution injectable, FLUOROURACILE ACCORD 50 mg/ml, solution à diluer pour perfusion, ELOXATINE 5 mg/ml, solution à diluer pour perfusion, Xeloda 150 mg film-coated tablets

Primary endpoint: Proportion of curative surgery (R0 resection)
Endpoint(s): 3-year Disease Free and 3-year Overall Survival, Surgical morbidity and mortality (Dindo classification) during first 30 days after the surgery, Compliance to treatment: proportion of patients receiving full allocated neoadjuvant treatment, Proportion of good tumor response: LRRC with a decreasing size of 50% after preoperative treatment (defined as good MRI radiological responders according to previous data in the literature), Proportion of treatment related toxicity using International Common Terminology Criteria for Adverse Events (CTCAE) grading system v5.0, Quality of life (QLQ-C30 and QLQ-CR29) before neoadjuvant treatment, before surgery, 6 months, one year and two years after surgery

Source: https://euclinicaltrials.eu/ctis-public/view/2024-514705-62-00